EU clinical trial 2024-512835-53-00: LATE-R TRIAL: A PHASE II, SINGLE-ARM, OPEN-LABEL, MULTICENTER STUDY TO EVALUATE THE EFFICACY OF AXICABTAGENE CILOLEUCEL IN PATIENTS WITH LATE RELAPSE OF DIFFUSE LARGE B-CELL LYMPHOMA
Sponsor: Fundacion Geltamo (Patient organisation/association). Phase: Therapeutic exploratory (Phase II). Countries: Spain (ongoing, recruiting).
Therapeutic area(s): Diseases [C] - Hemic and Lymphatic Diseases [C15]
Gender: Female, Male. Age: 18-64 years, 65+ years. Enrolment: 45.
Status: Ongoing, recruiting. Start date (EU): 2024-11-20. Decision date: 2024-09-27. Results received: No. Last updated: 2024-09-27.

Condition(s): Diffuse Large B-Cell Lymphoma
Product: AXICABTAGENE CILOLEUCEL, CYCLOPHOSPHAMIDE, RoActemra 20 mg/mL concentrate for solution for infusion, FLUDARABINE

Primary endpoint: Complete Metabolic Response, defined as negative findings on a PET/CT scan at Month 3, after receiving axicabtagene ciloleucel infusion at day 0. The negativity of PET/CT findings will be assessed according to Lugano Classification and Deauville criteria
Endpoint(s): Complete metabolic response, defined as negative findings on a PET/CT scan at Month 3 after receiving axicabtagene ciloleucel infusion at day 0, as assessed by central imaging review of PET/CT, The Overall Response Rate, defined as the percentage of patients who achieved partial metabolic response or complete metabolic response according to the Lugano Classification criteria at Month 3 determined by both central and investigator assessments, Best objective response rate defined as the percentage of complete metabolic response + partial metabolic response determined by the investigator assessment among all patients between month 1 and month 12 from axicabtagene ciloleucel infusion, Best complete response rate defined as the percentage of complete metabolic response determined by the investigator assessment among all patients between month 1 and month 12 from axicabtagene ciloleucel infusion, Overall survival, defined as the time from inclusion to date of death from any cause. Alive patients will be censored at their last follow-up date, Progression free survival, defined as the time from axicabtagene ciloleucel infusion to the first observation of documented disease progression/relapse (based on investigator disease assessment or death due to any cause. If a patient has not progressed or died, progression free survival will be censored at the time of last visit with adequate assessment, Event-free survival, defined as the time from leukapheresis to any event preventing axicabtagene ciloleucel infusion if axicabtagene ciloleucel is never infused, or death, disease progression, or instauration of a new lymphoma therapy for lymphoma progression after axicabtagene ciloleucel infusion., Duration of Response, defined as the time from attainment of partial metabolic response or complete metabolic response to the date of first documented disease progression/relapse (based on investigator disease assessment) or death from any cause., Duration of complete response, defined as the time from achievement complete metabolic response to the date of first documented disease progression/relapse (based on investigator disease assessment) or death from any cause, Type, frequency and severity of adverse events and serious adverse events occurring after leukapheresis procedure to 28 days after the infusion of the study treatment, Type, frequency and severity of adverse events of special interest: Cytokine release syndrome, immune effector cell-associated neurotoxicity syndrome, hypogammaglobulinemia, prolonged cytopenias and infections and emergent secondary malignancies occurring after leukapheresis procedure to the end of follow-up (5 years), The patient quality of life assessed by the administration of the EORTC QLQ-C30, EQ-5D-5L, and QLQ-NHL-HG29 patient reported outcomes at screening and after 4 weeks of infusion and after 3 months of infusion, Correlation between total metabolic tumor volume pre-axicabtagene ciloleucel infusion and efficacy/toxicity, Biological exploratory endpoints described in relation to efficacy and toxicity based on correlation with biological parameters such as: Histologic, phenotypic, genomic, transcriptomic, and molecular characteristics of malignant cells and tumor microenvironment pre and post-treatment; Immune response markers in tumor and blood (cytokine levels, immune cells, and TCR repertoire); Minimal residual disease; Immune-escape mechanisms

Source: https://euclinicaltrials.eu/ctis-public/view/2024-512835-53-00